EU clinical trial 2024-518870-15-00: Multicenter, phase II, national and open-label study to evaluate Iberdomide-dexamethasone alone or in combination with standard MM treatment regimens in transplant ineligible newly diagnosed patients.
Protocol code: GEM-IBERDARAX
Sponsor: Fundacion PETHEMA (Patient organisation/association). Phase: Therapeutic exploratory (Phase II). Countries: Spain (ongoing, recruitment ended).
Therapeutic area(s): Diseases [C] - Hemic and Lymphatic Diseases [C15]
Gender: Female, Male. Age: 18-64 years, 65+ years. Enrolment: 140.
Status: Ongoing, recruitment ended. Start date (EU): 2022-10-03. Decision date: 2024-11-20. Results received: No. Last updated: 2026-08-03.

Condition(s): Multiple Myeloma
Product: Iberdomide, DARZALEX 1800 mg solution for injection, Iberdomide, Iberdomide

Primary endpoint: Overall Response Rate (ORR) with the different responses categories and especially the Complete Response Rate (CRR), defined as the percentage of participants with a confirmed complete response (CR) or better (stringent complete response (CR, sCR).
Endpoint(s): Minimal Residual Disease (MRD) negativity rate is defined as the percentage of participants who are MRD negative by next-generation flow cytometry (NGF), PET/CT, and mass spectrometry. Analysis of MRD will be done by NGF according to International Myeloma Working Group (IMWG)., Progression-Free Survival (PFS), defined as the time from the start date of the study treatment until the earliest date of documented disease progression or death due to any cause., Overall Survival (OS), defined as the time from the start date of the study treatment until the date of death due to any cause., Determine the relative distribution and immunophenotype of myeloid suppresser cells, monocytes and macrophages, antigen presenting cells, NK, B and T cells from baseline onto treatment, remission and disease progression., EQ-5D/5L, QLQ-C30 and MY20 questionnaires, at baseline and at months 4, 8, 12, 18, and 24., - Incidence of deaths and primary cause of death. - Data for vital signs. - Incidence of adverse events (AEs). - Percentage of patients discontinuing therapy due to AEs. - Percentage of patients requiring dose modifications. - Changes in laboratory analytes from the hematology and blood chemistry panel., Time to Progression (TTP)., Time from start therapy to second disease progression or to the moment in which the third line of therapy starts: PFS2., Overall survival (OS).

Source: https://euclinicaltrials.eu/ctis-public/view/2024-518870-15-00